EU clinical trial 2023-507271-21-00: A Multicenter, Randomized, Double-blind, Placebo-controlled Phase 3 Study of the Bruton’s Tyrosine Kinase (BTK) Inhibitor, Ibrutinib, in Combination with Rituximab versus Placebo in Combination with Rituximab in Treatment Naïve Subjects with Follicular Lymphoma
Protocol code: PCYC-1141-CA
Sponsor: AbbVie Deutschland GmbH & Co. KG (Pharmaceutical company). Phase: Therapeutic confirmatory (Phase III). Countries: Italy (ended), Greece (ended), Austria (ended), Netherlands (ended), Hungary (ended), Czechia (ended), Poland (ended), Belgium (ended), Spain (ended), Portugal (ended), France (ended).
Therapeutic area(s): Diseases [C] - Hemic and Lymphatic Diseases [C15]
Gender: Female, Male. Age: 18-64 years, 65+ years. Enrolment: 231.
Status: Ended. Start date (EU): 2017-04-11. End date (EU): 2025-06-09. End date: 2025-06-10. Decision date: 2024-02-19. Results received: Yes. Last updated: 2025-04-29.
Decision dates by country: GR: 2024-04-01, FR: 2024-02-20, IT: 2024-02-19, PL: 2024-03-15, NL: 2024-02-19, HU: 2024-02-19, BE: 2024-02-19, AT: 2024-02-23, PT: 2024-02-19, ES: 2024-02-21, CZ: 2024-02-20

Condition(s): Follicular Lymphoma
Product: Ibrutinib hard capsule for oral use, Ibrutinib

Primary endpoint: Progression-free survival (PFS)
Endpoint(s): • Overall response rate (ORR) (Cheson 2014), • Overall Survival (OS), • Infusion-related reaction rate (Arm A vs. Arm B), • Duration of response (DOR) as assessed by investigator, • Frequency, severity, seriousness, and relatedness of adverse events (AEs)

Source: https://euclinicaltrials.eu/ctis-public/view/2023-507271-21-00